EU clinical trial 2024-513656-15-00: A Clinical Study to Assess the Safety, Tolerability of JNJ-63733657 and to evaluate how fast and to what extent JNJ-63733657 reaches the bloodstream and is absorbed, modified and removed from the body when administered as a Subcutaneous Infusion Using a Syringe Pump and as an Intravenous Infusion in Healthy Adult Participants
Protocol code: 63733657EDI1003
Sponsor: Janssen Cilag International (Pharmaceutical company). Phase: Human Pharmacology (Phase I)- Other. Countries: Belgium (ended).
Therapeutic area(s): Diseases [C] - Nervous System Diseases [C10]
Gender: Female, Male. Age: 18-64 years, 65+ years. Enrolment: 90.
Status: Ended. Start date (EU): 2022-10-17. End date (EU): 2025-05-21. Decision date: 2024-06-19. Results received: No. Last updated: 2025-03-10.
Decision dates by country: BE: 2024-08-27

Condition(s): Alzheimer's Disease (Healthy Participants)

Source: https://euclinicaltrials.eu/ctis-public/view/2024-513656-15-00